EU clinical trial 2025-523264-21-00: CIRAANO: Multimodal exploration (including radiopharmaceuticals Amyvid® and Tauvid®) of theater actors, memory athletes, and patients with various memory pathologies: evaluation of mnesic strategies and their cerebral substrates, and contribution to the treatment of memory pathologies.
Protocol code: C24-50
Sponsor: Institut National De La Sante Et De La Recherche Medicale (Laboratory/Research/Testing facility). Phase: Phase II and Phase III (Integrated). Countries: France (ongoing, recruiting).
Therapeutic area(s): Psychiatry and Psychology [F] - Mental Disorders [F03]; Analytical, Diagnostic and Therapeutic Techniques and Equipment [E] - Investigative Techniques [E05]; Diseases [C] - Pathological Conditions, Signs and Symptoms [C23]
Gender: Female, Male. Age: 18-64 years, 65+ years. Enrolment: 600.
Status: Ongoing, recruiting. Start date (EU): 2026-06-04. Decision date: 2026-01-23. Results received: No. Last updated: 2026-01-23.

Condition(s): Semantic Variant Primary Progressive Aphasia, Alcohol Use Disorder, Organic amnesia syndrome, Narcolepsy, Alzheimer, Lewy Body Dementia
Product: FLORTAUCIPIR (18F), FLORTAUCIPIR (18F), FLORBETAPIR (18F), FLORBETAPIR (18F)

Primary endpoint: [Part 2 - Objective 1] Volume measurements (from T1 MRI) and perfusion measurements (from early-phase Amyvid® PET) in the 4 brain networks in each patient group and in controls
Endpoint(s): [Part 1 - Objective 1] Number of participants having successfully completed all examinations necessary for the evaluation of the main judgement criterion of CIRAANO, [Part 1 - Objective 2] Score obtained on the acceptability scale, Behavioral data collected using the various questionnaires, Raw scores from neuropsychological tests, Scores from the directed forgetting task (number of “To Remember” and “To Forget” words identified as new or previously seen), Composite scores by cognitive function and domain (lifestyle factors, sleep, psycho-affective or subjective evaluation) assessed by neuropsychological tests and questionnaires. Composite scores correspond to an average of standardized z-scores, calculated from the raw scores collected in the control group for the corresponding function (scores presenting a normal distribution and without floor/ceiling effects), Ranking position in the national memory sports classification (for the memory athlete group), Theater experience and practice, in terms of time and number of plays learned (for the actor group), Gray matter volume measured in each voxel of the brain, Volume of the hippocampus and hippocampal subfields, Volume of the thalamus and thalamic subregions, Mean intensity value of the locus coeruleus, Cerebral perfusion measured in each voxel of the brain, Fractional anisotropy, mean diffusivity, and mean kurtosis in each voxel of the brain, Number, size, and location of white matter lesions, Functional brain connectivity, Beta-amyloid burden (from the radiopharmaceutical Amyvid®) measured in each voxel of the brain and overall mean in gray matter, Burden of neurofibrillary tangles or abnormally phosphorylated Tau protein (from the radiopharmaceutical Tauvid®) measured in each voxel of the brain and overall mean in the temporal region, Brain activity measured by fMRI specifically associated with recall, encoding, and learning from the text learning task (compared to activity measured during control tasks of reading and verbal articulation), Data collected during EEG recording associated with the passive listening task of auditory stimuli, Spontaneous oscillatory activity (EEG) in a resting state, Subjective sleep measures collected through sleep questionnaires, Data collected through actigraphy, Data collected through polysomnographic recordings, Data collected through the SomnoArt® device, Blood measures, Anthropometric and physical measures (from the medical interview, ECG analysis from polysomnographic recording during a wakeful state), Measurement of liver fibrosis using Fibroscan®, Scores from questionnaires and information about the relative (age, type of relationship with the participant, frequency of meetings, number of years of relationship) provided by the accompanying persons/informants depending on the participant’s group

Source: https://euclinicaltrials.eu/ctis-public/view/2025-523264-21-00